EU clinical trial 2025-524318-27-00: VIP-1 : Preclinical type 1 diabetes: the VIP-1 Study
Protocol code: APHP250532
Sponsor: Assistance Publique Hopitaux De Paris (Hospital/Clinic/Other health care facility). Phase: Therapeutic exploratory (Phase II). Countries: France (authorised, recruitment pending).
Therapeutic area(s): Diseases [C] - Immune System Diseases [C20]; Diseases [C] - Hormonal diseases [C19]
Gender: Female, Male. Age: 0-17 years, 18-64 years. Enrolment: 50.
Status: Authorised, recruitment pending. Decision date: 2026-08-05. Results received: No. Last updated: 2026-08-05.

Condition(s): People with stage 1 or stage 2 T1D between the ages of 7 and 45
Product: VERAPAMIL HYDROCHLORIDE, Placebo of Verapamil LP 120mg

Primary endpoint: Beta-cell function - measured by disposition index during OGTT - after 48 weeks of treatment.
Endpoint(s): Proinsulin-to-C-peptide ratio during OGTT at baseline, 24 and 48 weeks, Chromogranin A/GLP-1/GIP during OGTT at baseline, 24 and 48 weeks, Changes in disposition index components: insulin sensitivity and insulin secretion measured by metabolic modelling during 24-week and 48 weeks OGTT., CD4+/CD8+ T-cell responses of peripheral blood monocytes to type 1 diabetes-associated antigens at baseline and 48 weeks, Percentage change in time spent in glucose ranges (70-140 mg/dL, 70-180 mg/dL) and glucose variability (SD, CV, CONGA1, 2 and 4) during sensor sessions (CGM) at 10 days, 24 and 48 weeks after treatment initiation

Source: https://euclinicaltrials.eu/ctis-public/view/2025-524318-27-00